EU clinical trial 2022-501707-27-01: European Clinical Research Alliance on Infectious Diseases – primary care adaptive platform trial for pandemics and epidemics (ECRAID-Prime)
Protocol code: EU-EcraidPC-1
Sponsor: University Medical Center Utrecht (Hospital/Clinic/Other health care facility). Phase: Phase II and Phase III (Integrated). Countries: Germany (ongoing, recruitment ended), France (ongoing, recruitment ended), Belgium (ongoing, recruitment ended), Poland (ongoing, recruitment ended), Ireland (ongoing, recruitment ended), Spain (ongoing, recruitment ended).
Therapeutic area(s): Diseases [C] - Virus Diseases [C02]
Gender: Female, Male. Age: 18-64 years, 65+ years. Enrolment: 911.
Status: Ongoing, recruitment ended. Start date (EU): 2024-10-03. Decision date: 2024-04-08. Results received: No. Last updated: 2026-04-08.
Decision dates by country: FR: 2024-07-31, BE: 2024-04-08, PL: 2024-04-10, IE: 2024-04-10, DE: 2024-04-09, ES: 2024-06-05

Condition(s): COVID-like-illness, COVID-19
Product: Nitric Oxide Nasal Spray (NONS), Placebo nasal sprays are identical to LTX-109 nasal sprays, and will be relabelled identical. Placebo nasal sprays will have the same composition, except for the active substance., SALINE NASAL SPRAY (0.9% NACL)

Primary endpoint: Time to first self-report of feeling recovered from symptoms related to COVID-19 or COVID-like-illness., Viral clearance and potentially reduction in viral load and/or impact on biomarkers of illness severity (for Phase IIa type evaluation) from baseline to ISA-specified days between day 1 and 14, LTX-109 specific: Viral clearance by LTX-109 nasal spray (0.5% w/w) measured at Day 3 after inclusion as compared to placebo nasal spray (0% LTX-109)
Endpoint(s): Time to first self-report of return to usual daily activity., Presence, duration, and severity of individual respiratory symptoms (runny/congested nose, sore throat, cough, fever shortness of breath, fatigue/tiredness, sweats/chills, headache, muscle, joint and/or body aches, loss of taste/smell, diarrhoea, other) as: absent, mild, moderate, severe., Participant reported overall wellbeing, reported by rating of how well participant feels (scale 0-10), Impact on usual daily activities (work/education, caring for (grand-) children, household activities, sports, social life), as: no, slight, moderate, severe, not applicable., Complications (e.g. hospitalisation, death; all cause, non-elective hospitalisation)., Health care utilisation for COVID-19 or COVID-like-illness (GP and hospital visits)., Long-term consequences of COVID-19 or COVID-like-illness (e.g. cough, shortness of breath and/or difficulty breathing, fast heart rate, fatigue, tiredness and/or loss of energy, sleep alterations, loss of smell and/or taste, emotional sensitivity, depression and/or anxiety, concentration problems and/or difficulty thinking, muscle aches and or generalised body pains, diarrhoea and/or stomach pain, other)., The incidence of COVID-19 and COVID-like-illness in other members of the household (using participants diaries and/or swabbing the symptomatic household member(s))., Exploratory: Emergence of mutations in causative pathogens in index cases and potentially in household members, Exploratory: Experiences of researchers and network coordinators of setting up the trial in multiple countries, including views on optimising trial delivery, recruitment, and implementation (qualitative study)., Exploratory: Healthcare professionals’ views and experience of taking part in the trial (in the context of a pandemic), the novel trial design, recruiting patients and views on the intervention(s) (qualitative study)., Exploratory: Patient views and experiences of taking part in the trial and trial interventions, including how they conceptualise their illness and recovery (qualitative study)., Time to first self-report of feeling recovered from symptoms of COVID-19 or COVID-like-illness (for Phase IIa type evaluation), Viral clearance at ISA-specified days, The use of additional antiviral medication (yes/no, name of medication), The use of other prescribed and/or over-the-counter medication for the respiratory infection (antibiotics, antiviral medication, ibuprofen, other pain/fever medication, inhaled medication, intranasal medication, other), Sustained recovery (participants’ reported recovery that was maintained until 28 days)., Key secondary outcome: Early sustained recovery (recovery by day 14 sustained until day 28), Overall safety of the IP by reporting (serious) adverse drug reactions, LTX-109 specific: Viral load reduction from Day 0 (baseline) to Day 1, to Day 3 and to Day 5, LTX-109 specific: Viral clearance at Day 1 and Day 5, Reduction in viral load from baseline to ISA specified days, Tolerability of the IP, via reasons for stopping IP intake.

Source: https://euclinicaltrials.eu/ctis-public/view/2022-501707-27-01